EU clinical trial 2023-505976-31-00: A Multicenter, Randomized, Parallel-group, Double-blind, Two-arm, Phase III Study to Evaluate the Safety and Efficacy of Anifrolumab Compared with Placebo in Male and Female Participants 18 to 70 Years of Age Inclusive with Systemic Sclerosis
Protocol code: D3460C00002
Sponsor: Astrazeneca AB (Pharmaceutical company). Phase: Therapeutic confirmatory (Phase III). Countries: Austria (ongoing, recruitment ended), Poland (ongoing, recruitment ended), Hungary (ongoing, recruitment ended), Romania (ongoing, recruitment ended), Spain (ongoing, recruitment ended), Germany (ongoing, recruitment ended), Italy (ongoing, recruitment ended), Netherlands (ongoing, recruitment ended), France (ongoing, recruitment ended), Belgium (ongoing, recruitment ended).
Therapeutic area(s): Diseases [C] - Skin and Connective Tissue Diseases [C17]
Gender: Female, Male. Age: 18-64 years, 65+ years. Enrolment: 112.
Status: Ongoing, recruitment ended. Start date (EU): 2023-11-24. Decision date: 2023-09-20. Results received: No. Last updated: 2026-07-17.
Decision dates by country: HU: 2023-09-27, NL: 2023-09-27, BE: 2023-09-26, PL: 2023-10-02, DE: 2023-09-26, IT: 2023-09-27, FR: 2023-09-29, ES: 2023-09-20, RO: 2023-10-02, AT: 2023-10-02

Condition(s): Systemic Sclerosis (SSc) presenting with Limited or Diffuse Cutaneous Subsets, Autoimmune diseases, Interstitial lung disease (ILD), Immune system diseases
Product: Anifrolumab, Anifrolumab Placebo, ANIFROLUMAB

Primary endpoint: Proportion achieving Revised Composite Response Index in Systemic Sclerosis-25 (Revised-CRISS-25) response where Revised-CRISS-25 is a composite endpoint in which a responder is defined as a participant who meets all the following criteria:, Improvement in at least 2 components [≥ 5% increase for Percent predicted forced vital capacity (ppFVC) and/or≥ 25% decrease for mRSS, HAQ-DI, PtGA, Clinician Global Assessment (CGA), Worsening in no more than one component (≥ 5% decrease for ppFVC and/or ≥ 25% increase for mRSS, HAQ-DI, PtGA, CGA), No significant SSc-related event as defined in Step 1 (Khanna et al 2021), Otherwise, a participant is a non-responder
Endpoint(s): Treatment related difference in mean change from baseline in pulmonary function, Treatment related difference in mean change from baseline in mRSS, Treatment related difference in proportion achieving Revised-CRISS-25 components, Treatment related difference in proportion achieving interstitial lung disease progression, Treatment related difference in patient reported outcomes based on the Scleroderma Skin patient reported outcome, Evaluate the pharmacokinetics (PK), pharmacodynamics (PD) and immunogenicity of subcutaneous Anifrolumab, Treatment related difference in safety and tolerability with or without standard therapy in participants with SSc, Long term treatment related difference in safety and tolerability with or without standard therapy in participants with SSc

Source: https://euclinicaltrials.eu/ctis-public/view/2023-505976-31-00